EU clinical trial 2025-523699-21-00: An open label safety and efficacy study of allogenic adipose tissue-derived mesenchymal stromal cells on autism and gastrointestinal symptoms
Sponsor: Cell to Cure ApS (Pharmaceutical company). Phase: Human Pharmacology (Phase I)- Other. Countries: Denmark (not authorised).
Therapeutic area(s): Psychiatry and Psychology [F] - Mental Disorders [F03]; Diseases [C] - Digestive System Diseases [C06]
Gender: Female, Male. Age: 0-17 years. Enrolment: 40.
Status: Not authorised. Decision date: 2026-01-23. Results received: No. Last updated: 2026-01-23.

Condition(s): Gastrointestinal symptoms, Autism spectrum disorder
Product: C2C_ASC110, C2C_ASC66

Primary endpoint: Number of adverse reactions (ARs) and serious adverse reactions (SARs)
Endpoint(s): Change in Vineland Adaptive Behavior Scales (questionnaire), Change in Children Communication Checklist-2 (questionnaire), Change in IBS-QoL - Irritable Bowel Syndrome Quality of Life (questionnaire)

Source: https://euclinicaltrials.eu/ctis-public/view/2025-523699-21-00